EU clinical trial 2025-520673-39-00: Click-cleavable imaging in HER2-positive cancers (CleavHER trial).
Protocol code: 116650
Sponsor: Radboud universitair medisch centrum Stichting (Hospital/Clinic/Other health care facility). Phase: Human Pharmacology (Phase I)- First administration to humans. Countries: Netherlands (ongoing, recruiting).
Therapeutic area(s): Analytical, Diagnostic and Therapeutic Techniques and Equipment [E] - Diagnosis [E01]; Diseases [C] - Neoplasms [C04]
Gender: Female, Male. Age: 18-64 years, 65+ years. Enrolment: 28.
Status: Ongoing, recruiting. Start date (EU): 2026-04-02. Decision date: 2025-08-07. Results received: No. Last updated: 2026-03-25.

Condition(s): HER2-positive tumors

Source: https://euclinicaltrials.eu/ctis-public/view/2025-520673-39-00